EU clinical trial 2023-506187-14-00: Extending omalizumab treatment intervals in patients with chronic spontaneous urticaria (EXOTIC trial): a multicentre, randomized, open-label, non-inferiority trial.
Sponsor: Bispebjerg Hospital (Hospital/Clinic/Other health care facility). Phase: Phase III and phase IV (Integrated). Countries: Denmark (ended).
Therapeutic area(s): Diseases [C] - Skin and Connective Tissue Diseases [C17]
Gender: Female, Male. Age: 18-64 years. Enrolment: 40.
Status: Ended. Start date (EU): 2024-01-12. End date (EU): 2026-01-09. Decision date: 2023-11-24. Results received: No. Last updated: 2025-06-13.

Condition(s): Chronic spontaneous urticaria
Product: Xolair 150 mg solution for injection in pre-filled syringe

Primary endpoint: Absolute difference in average urticaria control test (UCT) score between treatment arms at week 36.

Source: https://euclinicaltrials.eu/ctis-public/view/2023-506187-14-00